EU clinical trial 2022-501047-32-00: A Phase 1b, 2-part, placebo-controlled study to evaluate the efficacy, safety, and PK of PF-07054894 in participants with mild to severe UC.
Protocol code: C4151002
Sponsor: Pfizer Inc. (Pharmaceutical company). Phase: Human Pharmacology (Phase I)- Other. Countries: Germany (ended), Poland (ended).
Therapeutic area(s): Diseases [C] - Digestive System Diseases [C06]
Gender: Female, Male. Age: 18-64 years, 65+ years. Enrolment: 35.
Status: Ended. Start date (EU): 2023-05-30. End date (EU): 2025-11-05. End date: 2025-11-11. Decision date: 2023-03-14. Results received: No. Last updated: 2025-10-08.
Decision dates by country: PL: 2023-03-20, DE: 2023-03-14

Condition(s): ULCERATIVE COLITIS

Source: https://euclinicaltrials.eu/ctis-public/view/2022-501047-32-00